EU clinical trial 2022-501123-24-00: Pathophysiology of pain in Parkinson's disease: exploration of the serotonin system in positron emission tomography (PET [18F]-MPPF) - PD PAIN
Protocol code: RC31/21-0566
Sponsor: Centre Hospitalier Universitaire De Toulouse (Hospital/Clinic/Other health care facility). Phase: Therapeutic exploratory (Phase II). Countries: France (ongoing, recruiting).
Therapeutic area(s): Diseases [C] - Nervous System Diseases [C10]
Gender: Female, Male. Age: 18-64 years, 65+ years. Enrolment: 34.
Status: Ongoing, recruiting. Start date (EU): 2024-06-10. Decision date: 2023-05-17. Results received: No. Last updated: 2025-12-04.

Condition(s): Parkinson's disease
Product: 18F-MPPF

Primary endpoint: The primary endpoint is the distribution volume ratio of [18F]-MPPF (DVR) using the cerebellum as the reference region, measured in both groups of painful and non-painful PD patients
Endpoint(s): assess the relationship between [18F]-MPPF uptake and : • central pain intensity, other central pain characteristics and pain-induced functional discomfort only in painful parkinsonian patients • pain perception thresholds in the 2 groups of patients, compare the functional networks related to pain on resting-state functional MRI between the 2 groups of patients;, evaluate, for the 2 groups of patients, the link between : • cerebral structural characteristics (cerebral macro/microstructural markers collected in MRI) and pain parameters (central pain intensity, and other pain characteristics, pain-induced functional discomfort and pain perception thresholds); • [18F]-MPPF uptake and pain-related functional networks in resting-state MRI

Source: https://euclinicaltrials.eu/ctis-public/view/2022-501123-24-00